EU clinical trial 2024-516088-10-00: Phase II study on the safety and efficacy of cysteamine in association with standard tuberculosis therapy for the treatment of patients with pulmonary tuberculosis: a new therapy for tuberculosis directed at the host.
Protocol code: CISTA-TB
Sponsor: National Institute For Infectious Diseases Lazzaro Spallanzani (Hospital/Clinic/Other health care facility). Phase: Therapeutic exploratory (Phase II). Countries: Italy (ongoing, recruiting).
Therapeutic area(s): Diseases [C] - Bacterial Infections and Mycoses [C01]
Gender: Female, Male. Age: 18-64 years. Enrolment: 30.
Status: Ongoing, recruiting. Start date (EU): 2024-10-16. Decision date: 2024-10-21. Results received: No. Last updated: 2025-07-17.

Condition(s): Pulmonary Tuberculosis
Product: CYSTAGON 50 mg hard capsules

Primary endpoint: Acceptability of treatment, Adherence: doses taken/expected doses of cysteamine., Tolerability of treatment., Pharmacokinetics of all administered drugs performed on plasma (dedicated test tube with EDTA as anticoagulant)., Evaluation of serious adverse events (SAEs) and unexpected events., Correlation of any AEs and SAEs with pharmacokinetic profiles.
Endpoint(s): Evaluate the effect of cysteamine on Mtb by molecular assay for bacterial load assessment (MBLA) at different time points (day 0, 7±1 and 28±3)., (Additional endpoint). Evaluation of biomarkers useful for therapy monitoring in different biological samples (blood, plasma, serum, cells, urine, sputum) at different time points [day 0, 7±1, 14±1, 28±3,60±3, end of therapy (month 6±3)] ((for example, cytokines/chemokines, cell counts, inflammatory factors, biochemical factors will be evaluated by multiparametric immunohistochemical methods and/or immunometric/enzymatic assays)., (Additional Endpoints). Immunological characterization of cysteamine activity. In particular, at different time points [day 0, 7±1, 14±1, 28±3, 60±3, end of therapy (month 6±3)], the following will be evaluated in peripheral blood mononuclear cells (PBMC) stimulated with Mtb-specific stimuli: cellular activation markers, cytokine production and memory profile (e.g. CD3, CD4, CD8, CD19, CD45RA, CD27, CCR7, CD38, CD25, HLA-DR, IFN-γg, TNF-αa,IL-2)by flow cytometry.Transcriptome will be evaluated

Source: https://euclinicaltrials.eu/ctis-public/view/2024-516088-10-00